EU clinical trial 2023-507758-34-00: A randomised, placebo-controlled, double-blinded, cross-over, Phase 1 study evaluating the safety and preliminary efficacy of the GLP 1 analogue ROSE-010 on appetite and food intake in overweight and obese subjects.
Protocol code: RP-23-01
Sponsor: Rose Pharma Inc. (Pharmaceutical company). Phase: Human Pharmacology (Phase I)- Other. Countries: Sweden (ended).
Therapeutic area(s): Diseases [C] - Nutritional and Metabolic Diseases [C18]
Gender: Female, Male. Age: 18-64 years, 65+ years. Enrolment: 12.
Status: Ended. Start date (EU): 2023-11-10. End date (EU): 2024-01-16. Decision date: 2023-11-09. Results received: Yes. Last updated: 2023-11-09.

Condition(s): Overweight, Obesity
Product: Placebo injection solution: Sterile physiological saline solution (0.9% NaCl water for injection) will be used as the reference product. For blinding purposes, the placebo formulation is identical in appearance to ROSE-010; a clear colourless solution., Alvedon 500 mg brustabletter

Primary endpoint: Amount of food consumed during the ad libitum lunch served at the clinic after administration of ROSE-010 at two dose levels, as compared to placebo.
Endpoint(s): Hunger score on a visual analogue scale (VAS) 0-100 mm measured 1, 2, 3, 4, 5, and 6 hours after start of lunch intake., Satiety score on a VAS 0-100 mm measured 1, 2, 3, 4, 5, and 6 hours after start of lunch intake., Prospective consumption score on a VAS 0-100 mm measured 1, 2, 3, 4, 5, and 6 hours after start of lunch intake., Desire to eat score on a VAS 0-100 mm measured 1, 2, 3, 4, 5, and 6 hours after start of lunch intake., - Frequency, intensity, and seriousness of adverse events (AEs), and AEs leading to treatment/study discontinuation. - Changes from baseline in laboratory parameters and clinical safety parameters. - Incidence and severity of nausea as measured on a VAS 0-100 mm measured 1, 2, 3, 4, 5, and 6 hours after start of lunch intake.

Source: https://euclinicaltrials.eu/ctis-public/view/2023-507758-34-00